EU clinical trial 2025-522957-20-00: A Phase 3, Randomized, Double-Blind, 48-Week Placebo-Controlled Study to Assess the Efficacy, Safety, and Tolerability of DYNE-101 Administered to Participants with Myotonic Dystrophy Type 1
Protocol code: DYNE101-DM1-301
Sponsor: Dyne Therapeutics Inc. (Pharmaceutical company). Phase: Therapeutic confirmatory (Phase III). Countries: Netherlands (authorised, recruitment pending), Spain (authorised, recruiting), Italy (authorised, recruitment pending), Denmark (authorised, recruiting), Germany (ongoing, recruiting), Belgium (ongoing, recruiting), France (authorised, recruiting).
Therapeutic area(s): Diseases [C] - Musculoskeletal Diseases [C05]; Diseases [C] - Nervous System Diseases [C10]
Gender: Female, Male. Age: 0-17 years, 18-64 years. Enrolment: 72.
Start date (EU): 2026-05-29. Decision date: 2026-04-28. Results received: No. Last updated: 2026-08-07.
Decision dates by country: BE: 2026-04-28, IT: 2026-04-30, NL: 2026-04-28, DK: 2026-04-28, DE: 2026-04-29, ES: 2026-04-30, FR: 2026-04-28

Condition(s): Myotonic Dystrophy Type 1
Product: SODIUM CHLORIDE, DYNE-101

Primary endpoint: 5×STS time, change from baseline at Week 49
Endpoint(s): Change from baseline at Week 49 in: vHOT; middle finger QMT total CGI-C 10-MWRT velocity (m/s) PGI-C DM1-ACTIVC total score MDHI total PGI-S CGI-S 9-HPT MDHI subscale, Maximum observed drug concentration (Cmax) Time to maximum concentration (tmax) Area under the concentration-time curve (AUC) from hour 0 to the last measurable concentration (AUCtlast) AUC extrapolated to infinity (AUC∞) Apparent terminal elimination rate constant (λZ) Apparent terminal elimination half-life (t½) Plasma clearance (CL) Volume of distribution at the terminal phase (Vz), if appropriate Volume of distribution at steady state (Vss), if appropriate, Incidence of anti-drug antibodies (ADAs), * Treatment-emergent adverse events (TEAEs) including: - Treatment-emergent serious adverse events (SAEs) - TEAEs considered related to study drug - TEAEs leading to discontinuation from study drug and discontinuation from the study * Other clinically significant safety and tolerability observations including: - Vital sign findings - 12-lead electrocardiogram (ECG) findings -Clinical laboratory values *C-SSRS results

Source: https://euclinicaltrials.eu/ctis-public/view/2025-522957-20-00